EU clinical trial 2024-517701-81-01: Effect of citalopram on chest pain in patients with achalasia.
Sponsor: Amsterdam UMC Stichting (Patient organisation/association). Phase: Therapeutic use (Phase IV). Countries: Netherlands (ended).
Therapeutic area(s): Diseases [C] - Digestive System Diseases [C06]
Gender: Female, Male. Age: 18-64 years. Enrolment: 48.
Status: Ended. End date (EU): 2026-02-19. Decision date: 2024-12-23. Results received: Yes. Last updated: 2024-12-23.

Condition(s): Achalasia
Product: Citalopram CF 20 mg, filmomhulde tabletten, Placebo of citalopram 20mg

Primary endpoint: Global assessment of chest pain relief after 6 weeks of treatment with citalopram
Endpoint(s): Symptom frequency and symptom severity score (calculated from symptom diary), Health-related Quality of life (SF-36), Achalasia-specific health-related quality of life (Ach-HRQL), Hospital Anxiety and depression scale (HADS), Adverse events/ complications/ side-effects, Patients estimation about the received treatment (‘’Which treatment did you think you’ve received?’’), Symptom severity and time to perception during esophageal acid perfusion and threshold balloon pressure during esophageal barostat balloon distension test (sub-study).

Source: https://euclinicaltrials.eu/ctis-public/view/2024-517701-81-01